EU clinical trial 2024-511523-33-00: Long-Term Follow-up: Phase I/II clinical study to evaluate the safety and efficacy of the infusion of autologous CD34+ cells transduced with a lentiviral vector carrying the FANCA gene (orphan drug) in patients with Fanconi Anaemia Subtype A: FANCOLEN-I
Protocol code: RP-L102-0116-LTFU
Sponsor: Rocket Pharmaceuticals Inc. (Pharmaceutical company). Phase: Phase I and Phase II (Integrated)- Other. Countries: Spain (ongoing, recruiting).
Therapeutic area(s): Diseases [C] - Congenital, Hereditary, and Neonatal Diseases and Abnormalities [C16]
Gender: Female, Male. Age: 0-17 years. Enrolment: 9.
Status: Ongoing, recruiting. Start date (EU): 2020-05-28. Decision date: 2024-08-29. Results received: No. Last updated: 2026-03-20.

Condition(s): Fanconi anemia (subtype A)
Product: Fancalen

Primary endpoint: Safety Assessments: will include blood-based evaluation of integration site analysis (ISA) in peripheral blood mononuclear cells (including lineage-specific subsets as determined by flow cytometry), assessment of RCL (serum and blood cells) when relevant, and detailed history regarding adverse events including hospitalizations, administration of medications or therapies for bone marrow failure, and development of hematologic and non-hematologic malignancies.
Endpoint(s): Importantly, in settings of hematologic malignancy development, a blood sample will be obtained to enable determination of whether the malignant clone developed from a gene-corrected lineage or an uncorrected FA hematopoietic population by means of PCR for the transgene within the malignant population. Efficacy Assessments: will include blood-based evaluation of peripheral blood counts, and ongoing assessment of phenotypic correction via peripheral blood T-lymphocyte DEB chromosomal fragility

Source: https://euclinicaltrials.eu/ctis-public/view/2024-511523-33-00